EU clinical trial 2022-502378-17-00: A Randomized, Phase 2, Double-blind, Placebo-controlled Study to Investigate the Safety and Efficacy of KER-012 in Combination with Background Therapy in Adult Participants with Pulmonary Arterial Hypertension (TROPOS-Study)
Protocol code: KER-012-A201
Sponsor: Keros Therapeutics Inc. (Pharmaceutical company). Phase: Therapeutic exploratory (Phase II). Countries: Germany (ended), Portugal (ended), Poland (ended), Spain (ended), France (ended).
Therapeutic area(s): Diseases [C] - Cardiovascular Diseases [C14]
Gender: Female, Male. Age: 18-64 years, 65+ years. Enrolment: 35.
Status: Ended. Start date (EU): 2024-03-20. End date (EU): 2025-01-14. End date: 2025-03-13. Decision date: 2024-02-08. Results received: Yes. Last updated: 2025-06-02.
Decision dates by country: PL: 2024-02-09, ES: 2024-02-08, PT: 2024-02-12, DE: 2024-04-15, FR: 2024-02-08

Condition(s): Pulmonary Arterial Hypertension
Product: Placebo for KER-012, cibotercept

Primary endpoint: Change from Baseline in pulmonary vascular resistance (PVR) at Week 24.
Endpoint(s): Change from Baseline in the 6-minute walk distance (6MWD) at Week 24., Incidence of treatment-emergent adverse events (TEAEs), treatment-related TEAEs and discontinuations due to TEAEs; change from baseline in clinical laboratory values, vital signs, and electrocardiogram (ECG); incidence of anti-drug antibodies (ADA).

Source: https://euclinicaltrials.eu/ctis-public/view/2022-502378-17-00